EU clinical trial 2024-518740-20-00: FFCD 1605- OPTIPRIME: A phase II study evaluating FOLFOX + panitumumab according to a ‘stop-and-go’ strategy with a reintroduction loop after progression on fluoropyrimidine as maintenance treatment, as the first line in patients with metastatic colorectal adenocarcinoma without a RAS mutation
Protocol code: FFCD 1605 OPTIPRIME
Sponsor: Fondation Franc.Cancerologie Digestive (Hospital/Clinic/Other health care facility). Phase: Therapeutic exploratory (Phase II). Countries: France (ended), Belgium (ended).
Therapeutic area(s): Diseases [C] - Digestive System Diseases [C06]
Gender: Female, Male. Age: 18-64 years, 65+ years. Enrolment: 118.
Status: Ended. Start date (EU): 2018-04-26. End date (EU): 2025-05-19. Decision date: 2024-11-13. Results received: Yes. Last updated: 2024-11-14.
Decision dates by country: BE: 2024-11-13, FR: 2024-11-14

Condition(s): metastatic colorectal adenocarcinoma
Product: Xeloda 150 mg film-coated tablets, Folinic acid (as calcium folinate) 10 mg/ml solution for injection/infusion, ELOXATINE 5 mg/ml, solution à diluer pour perfusion, Vectibix 20 mg/ml concentrate for solution for infusion, FLUOROURACILE TEVA 1000 mg/20 ml, solution à diluer pour perfusion

Primary endpoint: Disease control duration.
Endpoint(s): Progression-free survival 1 (PFS1 or PFS), Progression-free survival 2 (PFS 2), Successive progression-free survivals (PFS3), 4 (PFS4), etc, The best tumour response, The early response rate at 6 weeks, The depth of response, Overall survival, Quality of life (EORTC QLQ C-30), The dose intensity, The adverse events, The predictive value of early evolution, The predictive value of the appearance of resistance mutation(s)

Source: https://euclinicaltrials.eu/ctis-public/view/2024-518740-20-00